EU clinical trial 2024-517298-26-00: Differences in absorption via oral route and via oral mucosa of hydrocortisone from 2-dimensionally printed dissolvable films in healthy volunteers and in adult patients with adrenal insufficiency.
Protocol code: K804
Sponsor: Universitaetsklinikum Heidelberg AöR (Hospital/Clinic/Other health care facility). Phase: Human Pharmacology (Phase I)- Bioequivalence Study. Countries: Germany (ongoing, recruiting).
Therapeutic area(s): Diseases [C] - Nutritional and Metabolic Diseases [C18]
Gender: Female, Male. Age: 18-64 years, 65+ years. Enrolment: 26.
Status: Ongoing, recruiting. Start date (EU): 2025-05-21. Decision date: 2025-03-12. Results received: No. Last updated: 2025-04-15.

Condition(s): adrenal insufficiency

Source: https://euclinicaltrials.eu/ctis-public/view/2024-517298-26-00